EU clinical trial 2024-514277-21-00: Prospective, multistage, two-arm, randomised, double-blind study on the efficacy and safety of treatment of mild to moderate actinic keratosis with a 5% potassium hydroxide solution versus placebo with different duration of treatment cycles
Protocol code: KOHPLAK
Sponsor: INFECTOPHARM Arzneimittel und Consilium GmbH (Pharmaceutical company). Phase: Therapeutic confirmatory (Phase III). Countries: Germany (ongoing, recruiting).
Therapeutic area(s): Diseases [C] - Skin and Connective Tissue Diseases [C17]
Gender: Female, Male. Age: 18-64 years, 65+ years. Enrolment: 630.
Status: Ongoing, recruiting. Start date (EU): 2025-03-19. Decision date: 2025-01-30. Results received: No. Last updated: 2026-04-14.

Condition(s): Actinic keratosis
Product: Solcera, Preserved water

Primary endpoint: Treatment success of the trial participants (“complete clearance” = complete, dermatoscopically confirmed remission of all actinic keratosis lesions of a trial participant that were present at the start of treatment and treated (with the investigational medicinal product)) at the control visit after the end of treatment (“EOT”, after the end of the off-phase of the 1st, 2nd or 3rd treatment cycle depending on the course of remission), evaluated separately for phase 1, 2 and 3.
Endpoint(s): Lesion-related treatment success ("complete remission") of the actinic keratosis lesions (present at the start of treatment and treated (with the investigational medicinal product)), for which a complete remission was documented (at least once) until the end of treatment ("EOT"), evaluated separately for phase 1, 2 and 3, Lesion-related treatment success ("complete remission") of the actinic keratosis lesions (present at the start of treatment and treated (with the investigational medicinal product)), for which a complete remission was documented (at least once) until the respective visit, at all visit (except at the end of treatment ("EOT")), evaluated separately for phase 1, 2 and 3, Lesion-related treatment success of actinic keratosis lesions (present at the start of treatment and treated (with the investigational medicinal product)) with complete remission taking into account relapses, at all visits, evaluated separately for phase 1, 2 and 3, Treatment success ("complete clearance") of the trial participants in relation to actinic keratosis lesions present at the start of treatment and treated (with the investigational medicinal product) and additionally separately in relation to all actinic keratosis lesions (i.e. including actinic keratosis lesions occurring in the treated area after the start of treatment), at all visits, evaluated separately for phase 1, 2 and 3, Treatment success of the trial participants without consideration of relapses in relation to actinic keratosis lesions present at the start of treatment and treated (with the investigational medicinal product) and additionally separately in relation to all actinic keratosis lesions (i.e. including actinic keratosis lesions occurring in the treated area after the start of treatment), at all visits, evaluated separately for phase 1, 2 and 3, Trial participants with "partial clearance" (at least 75% of actinic keratosis lesions (present at start of treatment and treated (with the investigational medicinal product)) with complete remission), at all visits, evaluated separately for phase 1, 2 and 3, Response to therapy: trial participants with at least one actinic keratosis lesion with complete remission, at all visits, evaluated separately for phase 1, 2 and 3, Percentage reduction in the number of lesions per trial participant compared to baseline (in relation to actinic keratosis lesions present at the start of treatment and treated (with the investigational medicinal product)), at all visits, evaluated separately for phase 1, 2 and 3, Trial participants with relapse: trial participants with relapse occurred after "complete clearance" (at least one actinic keratosis lesion (present at the start of treatment and treated (with the investigational medicinal product)) with relapse assessment), in relation to all trial participants and additionally separately in relation to trial participants with (previous) "complete clearance", in the period up to the follow-up visit, evaluated separately for phase 1, 2 and 3, Actinic keratosis lesions with relapse: actinic keratosis lesions (present at the start of treatment and treated (with the investigational medicinal product)) with relapse assessment, in relation to all actinic keratosis lesions and additionally separately in relation to actinic keratosis lesions with (previous) complete remission, in the period up to the follow-up visit, evaluated separately for phase 1, 2 and 3, Healing stage/condition of the actinic keratosis lesions over time at all visit, overall and according to localisation and size in relation to actinic keratosis lesions present at the start of treatment and treated (with the investigational medicinal product) and also separately in relation to all actinic keratosis lesions (i.e. including actinic keratosis lesions that occurred in the treated area after the start of treatment), evaluated separately for phase 1, 2 and 3, Efficacy, tolerability and overall assessment by the investigator and the trial participant in school grades (1-6, at the end of treatment ("EOT") and at the follow-up visit), evaluated separately for phase 1, 2 and 3, Adverse events, serious adverse events, side effects and serious side effects (with separate presentation of local reactions, query "Part of the expected/desired inflammatory reaction?", duration and separately duration in relation to the duration of treatment as well as number and duration after the end of treatment with the investigational medicinal product), evaluated separately for phase 1, 2 and 3, Dropouts (with reason for discontinuation and timepoint), evaluated separately for phase 1, 2 and 3, Compliance, evaluated separately for phase 1, 2 and 3

Source: https://euclinicaltrials.eu/ctis-public/view/2024-514277-21-00